EU clinical trial 2025-523515-11-00: A Study to Evaluate the Safety, Tolerability, Pharmacokinetics, and Pharmacodynamics of DNL628 in Participants with Early Alzheimer’s Disease
Protocol code: DNLI-K-0001
Sponsor: Denali Therapeutics Inc. (Pharmaceutical company). Phase: Human Pharmacology (Phase I)- First administration to humans. Countries: Netherlands (ongoing, recruiting).
Therapeutic area(s): Diseases [C] - Nervous System Diseases [C10]
Gender: Female, Male. Age: 18-64 years, 65+ years. Enrolment: 27.
Status: Ongoing, recruiting. Start date (EU): 2026-04-03. Decision date: 2026-02-18. Results received: No. Last updated: 2026-07-13.

Condition(s): Early Alzheimer's Disease

Source: https://euclinicaltrials.eu/ctis-public/view/2025-523515-11-00